EU clinical trial 2024-511335-10-01: Effects of closed-loop automatic control of the inspiratory fraction of oxygen (FiO2-C) on outcome of extremely preterm infants – a randomized controlled parallel group multicenter trial for safety and efficacy
Protocol code: FiO2-C
Sponsor: Universitaetsklinikum Tuebingen AöR (Hospital/Clinic/Other health care facility). Phase: Therapeutic confirmatory (Phase III). Countries: Germany (ended).
Therapeutic area(s): Diseases [C] - Congenital, Hereditary, and Neonatal Diseases and Abnormalities [C16]
Gender: Female, Male. Age: 0-17 years. Enrolment: 865.
Status: Ended. Start date (EU): 2018-07-01. End date (EU): 2026-06-24. End date: 2026-06-25. Decision date: 2024-08-12. Results received: No. Last updated: 2026-07-15.

Condition(s): Preterm infants with a gestational age (GA) at birth of 23+0/7 – 27+6/7 weeks
Product: OXYGEN PH.EUR.

Primary endpoint: The primary outcome I is a composite of any of the following: • Death • Severe retinopathy of prematurity (severe ROP, as defined in 7.3.1) • Chronic lung disease of prematurity (BPD, according to the physiological definition as defined in 7.3.2) • Necrotizing enterocolitis (NEC, as defined in 7.3.3) until discharge from hospital, The primary outcome II is a composite of any of the following: • death or neurodevelopmental impairment (defined as at least one of the following components: motor disability (GMFCS 2-5), language or cognitive delay (language composite score < 85 or cognitive composite score < 85 on Bayley Scales of Infant Development, 3rd edition) or severe visual or hearing impairment (need for a hearing aid or cochlear implant)) at 24 months corrected age.
Endpoint(s): Individual components of the primary outcome variables and developmental scores of the Bayley Scales of Infant Development (3rd edition)

Source: https://euclinicaltrials.eu/ctis-public/view/2024-511335-10-01